EU clinical trial 2024-519089-32-02: TCRaß+CD19+ depleted haploidentical stem cell transplantation followed by immunotherapy in patients with relapsed/resistant high-risk neuroblastoma
Protocol code: APLOaß-NB
Sponsor: IRCCS Istituto Giannina Gaslini (Hospital/Clinic/Other health care facility). Phase: Therapeutic exploratory (Phase II). Countries: Italy (ongoing, recruiting).
Therapeutic area(s): Diseases [C] - Nervous System Diseases [C10]
Gender: Female, Male. Age: 0-17 years, 18-64 years. Enrolment: 19.
Status: Ongoing, recruiting. Start date (EU): 2023-08-29. Decision date: 2025-01-31. Results received: No. Last updated: 2025-01-31.

Condition(s): Patient affected by high risk Neuroblastoma relapsed or in progression after first line treatment.
Product: Rixathon 100 mg concentrate for solution for infusion, Aplo-TCSE TCRaß+CD19+ depleto, Allogeneic peripheral blood-derived NK cells CD3- CD56+, Qarziba 4.5 mg/mL concentrate for solution for infusion, Melfalan Tillomed 50 mg polvere e solvente per soluzione iniettabile/infusione, TEPADINA 100 mg powder for concentrate for solution for infusion, Fludarabina Accord 25 mg/ml Concentrato per soluzione iniettabile o per infusione, Grafalon 20 mg/ml concentrato per soluzione per infusione

Primary endpoint: Overall Survival (OS)
Endpoint(s): Engraftment and donor chimerism analysis, Immune reconstitution (+30, +60, +90, +120, +180, +360), Infectious events, Transplant-related mortality (TRM), Progression-free Survival (PFS), Early and late transplant-related toxicities, Immunotherapy (antui-GD2 mAb)–related toxicities, Donor-derived NK-cells infusion–related toxicities, Disease response (INRC criteria), Acute and chronic GvHD, Antitumor activity of donor-derived NK-cells (graft-versus-tumor effect), Relevance of the donor NK cell selection criteria

Source: https://euclinicaltrials.eu/ctis-public/view/2024-519089-32-02